EU clinical trial 2025-522743-18-00: Psilocybin AsSisted pSychotherapy for the treatmENt of Gambling disordER : a pilot study
Protocol code: RC25_0105
Sponsor: Centre Hospitalier Universitaire De Nantes (Hospital/Clinic/Other health care facility). Phase: Therapeutic exploratory (Phase II). Countries: France (authorised, recruitment pending).
Therapeutic area(s): Psychiatry and Psychology [F] - Behavior and Behavior Mechanisms [F01]
Gender: Female, Male. Age: 18-64 years, 65+ years. Enrolment: 30.
Status: Authorised, recruitment pending. Decision date: 2026-01-21. Results received: No. Last updated: 2026-06-24.

Condition(s): Gambling disorder
Product: PCB2 (Placebo PEX010) capsules, PEX010 Psilocybin Capsules (1.0 mg psilocybin), PEX010 Psilocybin Capsules (5.0 mg psilocybin), PEX010 Psilocybin Capsules (25.0 mg psilocybin)

Primary endpoint: Protocol completion rate, defined as the proportion of randomized participants who completed all scheduled visits and procedures, including all PAP sessions/control sessions and follow-up assessments until the end of study participation.
Endpoint(s): Changes in mean scores (+ standard deviations) or proportions, in each arm, between baseline assessment (V0) and post-treatment assessment: - Personal self-efficacy (General Self-Efficacy Scale: GSES); - Clinical Global Impression-Severity (CGI-S); - self-compassion (Self-Compassion Scale: SCS); - spirituality (WHOQOL-SRPB);- intensity, frequency, and duration of craving episodes and daily journaling., Correlation between the intensity of the psychedelic experience, measured by the MEQ-30 score obtained post-administration, and the mean scores (+ standard deviations) or proportions at baseline of the following variables in the experimental arm: spirituality (WHOQOL-SRPB); self-compassion (SCS); treatment expectations (CEQ at baseline); personal self-efficacy (GSES); average dose of IMP administered during the two sessions; measurement of blind maintenance., Average scores (+ standard deviations) or proportions, in each arm: of HR and BP, assessed during administration sessions; expected acute effects (17-item behavior and mood observation grid), assessed during administration sessions; number, type, severity, and attributability of AEs (excluding expected acute effects), assessed during administration sessions and throughout the study;increased risk of suicide;therapeutic index and clinical improvement., Recruitment feasibility validated if the goal of participants within the planned inclusion period is achieved (CONSORT diagram ; participants continuing treatment to the end in each arm;Assessment of blind maintenance), self-reported acceptability by patients and caregivers: duration, number, and frequency of sessions; reasons for refusal to participate by eligible patients and dropouts

Source: https://euclinicaltrials.eu/ctis-public/view/2025-522743-18-00